EU clinical trial 2026-525740-15-00: Triple oral therapy with bempedoic acid vs usual care in early lipid management of patients with acute coronary syndrome
Protocol code: HCF – G114
Sponsor: Fondazione Per Il Tuo Cuore Onlus Denominabile Anche Fondazione Italiana Per La Lotta Alle Malattie Cardiovascolari Onlus Ed Anche Heart Care Foundation Hcf Onlus (Patient organisation/association). Phase: Therapeutic confirmatory (Phase III). Countries: Italy (authorised, recruitment pending).
Therapeutic area(s): Diseases [C] - Cardiovascular Diseases [C14]
Gender: Female, Male. Age: 18-64 years, 65+ years. Enrolment: 600.
Status: Authorised, recruitment pending. Decision date: 2026-07-17. Results received: No. Last updated: 2026-07-17.

Condition(s): Acute Coronary Syndrome

Source: https://euclinicaltrials.eu/ctis-public/view/2026-525740-15-00